EU clinical trial 2024-515201-26-00: A phase II randomized clinical trial of Tarlatamab as maintenance treatment after sequential chemo-radiotherapy vs sequential chemo-radiotherapy as standard treatment for limited stage SCLC patients not eligible for concurrent chemo-radiotherapy. MERLIN GECP 24/01
Protocol code: MERLIN (GECP 24/02)
Sponsor: Fundacion GECP (Patient organisation/association). Phase: Therapeutic exploratory (Phase II). Countries: Spain (ongoing, recruiting).
Therapeutic area(s): Diseases [C] - Neoplasms [C04]
Gender: Female, Male. Age: 18-64 years, 65+ years. Enrolment: 37.
Status: Ongoing, recruiting. Start date (EU): 2025-12-09. Decision date: 2025-10-02. Results received: No. Last updated: 2026-04-07.

Condition(s): Small cell lung cancer (SCLC)
Product: Tarlatamab

Primary endpoint: Efficacy of Tarlatamab as maintenance treatment assessed by progression free survival. PFS, defined as the time from enrollment to the date of the first documentation of disease progression according to RECIST 1.1 or death from any cause, whichever is earlier
Endpoint(s): 1. Describe the efficacy of Tarlatamab as maintenance treatment as assessed by objective response rate (ORR). Investigator-assessed ORR, defined as a confirmed complete response (CR) plus partial response (PR) according to RECIST 1.1., 2. OS at 6 months and 1 and 2 years, defined as the time from enrollment to the date of death from any cause, 3. PFS at 6 months and 1 and 2 years, defined as the time from enrollment to the date of death from any cause, 4. Evaluate the safety and tolerability of Tarlatamab as maintenance treatment., 5. Incidence of adverse events (AEs) describing their frequency and severity, study intervention discontinuations due to AEs and the grade of relationship with the study drugs according to CTCAE v5.0, 6. To study the tumour microenvironment at baseline and the antitumor immune response in peripheral blood throughout treatment and correlate the results to clinical outcomes, ORR, OS, and AEs.

Source: https://euclinicaltrials.eu/ctis-public/view/2024-515201-26-00